EU clinical trial 2024-515504-39-00: A phase I dose-escalation study testing the feasibility and the tolerance of infusion of a third party suicide gene-transduced anti-HLA-DPB1*0401 cytotoxic T cell clone in patients with HLA-DPB1*0401 positive hematologic malignancies and receiving an allotransplant from HLA-DPB1*0401 negative donors
Protocol code: RC16_0157
Sponsor: Centre Hospitalier Universitaire De Nantes (Hospital/Clinic/Other health care facility). Phase: Phase I and Phase II (Integrated)- First administration to humans. Countries: France (ongoing, recruitment ended).
Therapeutic area(s): Diseases [C] - Hemic and Lymphatic Diseases [C15]; Diseases [C] - Immune System Diseases [C20]
Gender: Female, Male. Age: 18-64 years, 65+ years. Enrolment: 6.
Status: Ongoing, recruitment ended. Start date (EU): 2020-02-09. Decision date: 2024-09-05. Results received: No. Last updated: 2025-09-12.

Condition(s): Patients with hematological malignancies (Cf. inclusion criteria) HLA-DPB1*04:01 positive allografted with a geno- or pheno- or haplo-identical donor or cord blood HLA-DPB1*04:01 negative

Source: https://euclinicaltrials.eu/ctis-public/view/2024-515504-39-00